EU clinical trial 2023-503600-83-00: A Phase 3B, Multi Center, Open-label Long-term Extension Study of Apremilast (CC-10004) in Pediatric Subjects from 6 Through 17 Years of Age with Moderate to Severe Plaque Psoriasis
Protocol code: CC-10004-PPSO-004
Sponsor: Amgen Inc. (Pharmaceutical company). Phase: Therapeutic confirmatory (Phase III). Countries: Spain (ended), Czechia (ended), Belgium (ended), Italy (ended).
Therapeutic area(s): Diseases [C] - Immune System Diseases [C20]
Gender: Female, Male. Age: 0-17 years. Enrolment: 53.
Status: Ended. Start date (EU): 2020-05-27. End date (EU): 2025-12-11. End date: 2025-12-12. Decision date: 2023-08-30. Results received: Yes. Last updated: 2025-09-05.
Decision dates by country: CZ: 2023-08-31, BE: 2023-08-30, IT: 2023-08-31, ES: 2023-09-01

Condition(s): Moderate to Severe Plaque Psoriasis
Product: Otezla 10mg, 20mg, 30 mg film-coated tablets, Otezla 10mg, 20mg, 30 mg film-coated tablets

Primary endpoint: Adverse Events: Type, frequency, severity, and relationship to apremilast from Week 0 (Visit 1) through end of Observational Follow-up for the entire study duration, Columbia-Suicide Severity Rating Scale (C-SSRS) Questionnaire to monitor depression, suicidal thoughts and behavior for the entire study duration, Tanner Staging. Assessment of sexual maturity at Week 0 (Visit 1) and then every 52 weeks. Also early termination visit., Body weight, height and BMI: Monitor growth - Height and body weight are measured at each visit
Endpoint(s): sPGA - Proportion of subjects with an sPGA score of clear (0) or almost clear (1) with at least a 2-point reduction from baseline

Source: https://euclinicaltrials.eu/ctis-public/view/2023-503600-83-00